EU clinical trial 2023-508489-14-00: A Phase II, Single-Arm, Open-Label Study Evaluating the Safety and Pharmacokinetics of the Intravenous Fixed‑Dose Combination (IV FDC) of Tiragolumab and Atezolizumab in Participants with Locally Advanced, Recurrent or Metastatic Solid Tumors
Protocol code: GO44096
Sponsor: F. Hoffmann-La Roche AG (Pharmaceutical company). Phase: Therapeutic exploratory (Phase II). Countries: Cyprus (ended), Croatia (ended), Spain (ended), Greece (ended).
Therapeutic area(s): Diseases [C] - Neoplasms [C04]
Gender: Female, Male. Age: 18-64 years, 65+ years. Enrolment: 20.
Status: Ended. Start date (EU): 2023-09-18. End date (EU): 2024-03-25. End date: 2025-12-26. Decision date: 2024-02-20. Results received: Yes. Last updated: 2025-06-26.
Decision dates by country: GR: 2024-04-01, CY: 2024-02-22, ES: 2024-02-20, HR: 2024-02-22

Condition(s): Solid Tumors

Primary endpoint: 1. Incidence and severity of adverse events, with severity determined according to the National Cancer Institute Common Terminology Criteria for Adverse Events, Version 5.0 (NCI CTCAE v5.0) – The severity of CRS will also be determined according to the ASTCTCRS American Society for Transplantation and Cellular Therapy cytokine release syndrome Consensus Grading Scale.
Endpoint(s): 1. Area under the concentration time curve of tiragolumab and atezolizumab at Cycle 1, 2. Maximum serum concentration (Cmax) of tiragolumab and atezolizumab at Cycle 1, 3. Minimum serum concentration (Cmin) of tiragolumab and atezolizumab at Cycle 1, 4. Prevalence of anti-drug antibodies (ADAs) to tiragolumab at baseline and the incidence of treatment emergent ADAs to tiragolumab during the study, 5. Prevalence of ADAs to atezolizumab at baseline and the incidence of treatment emergent ADAs to atezolizumab during the study

Source: https://euclinicaltrials.eu/ctis-public/view/2023-508489-14-00